EU clinical trial 2025-520798-38-00: Randomised, double-blind, multicentre clinical trial to evaluate the efficacy and safety of topical metformin in adjuvant to daylight photodynamic therapy in actinic keratoses.
Protocol code: ICI21/00031
Sponsor: Fundacion Instituto De Investigacion Sanitaria Aragon (Laboratory/Research/Testing facility). Phase: Therapeutic exploratory (Phase II). Countries: Spain (authorised, recruitment pending).
Therapeutic area(s): Diseases [C] - Skin and Connective Tissue Diseases [C17]
Gender: Female, Male. Age: 18-64 years, 65+ years. Enrolment: 135.
Status: Authorised, recruitment pending. Decision date: 2025-01-30. Results received: No. Last updated: 2025-01-30.

Condition(s): Actinic keratoses
Product: METFORMIN, The placebo components are propylene glycol, neoPCLO/W, fenonip XB and purified water., METHYL AMINOLEVULINATE

Primary endpoint: Patients will receive treatment for 12 weeks and will be observed for 36 weeks after completion of treatment to assess clinical efficacy and adverse effects.

Source: https://euclinicaltrials.eu/ctis-public/view/2025-520798-38-00